EU clinical trial 2024-510772-20-00: PRODIGE 90 - FFCD 2204 - PREDIR-NEOREC - Neoadjuvant dostarlimab with short course radiotherapy in a watch-and-wait strategy for microsatellite unstable or mismatch repair-deficient locally advanced rectal cancer patients: a randomized phase II trial
Sponsor: Centre Hospitalier Universitaire De Dijon (Hospital/Clinic/Other health care facility). Phase: Therapeutic exploratory (Phase II). Countries: France (ongoing, recruiting).
Therapeutic area(s): Diseases [C] - Digestive System Diseases [C06]
Gender: Female, Male. Age: 18-64 years, 65+ years. Enrolment: 68.
Status: Ongoing, recruiting. Start date (EU): 2025-02-06. Decision date: 2024-07-31. Results received: No. Last updated: 2026-02-13.

Condition(s): Rectal cancer locally advanced with microsatellite unstable or mismatch repair-deficient
Product: JEMPERLI 500 mg concentrate for solution for infusion

Primary endpoint: The primary objective is to evaluate the treatment strategy failure (TSF) rate at 24 months from the date of randomization.
Endpoint(s): Adverse events (AEs) assessed according to NCI-CTCAE v5.0 will be presented by the number of patients with at least one AE by maximum grade and by causality to treatment (dostarlimab)., Disease Free Survival (DFS): DFS is defined by the time between the date of randomization and the date of disease recurrence including local, locoregional or metastatic relapse, second colorectal cancer, death whatever the cause of death. Patients alive without recurrence or second cancer will be censored at date of last news. The rate of alive patients without recurrence or second cancer will be done at 6, 12, 24 and 36 months., Overall survival (OS): OS is defined by the time between the date of randomization and the date of death (regardless of the cause). Alive patients will be censored at date of last news. The rate of alive patients will be done at 6, 12, 24 and 36 months, The rate of organ preservation at 2 years is defined at the rate of patients without resection of primary tumor (local excision, TME surgery, permanent colostomy/ileostomy) at 2 years. The rate of local excision, TME (total mesorectal excision) surgery or creation of a permanent colostomy/ileostomy at 2 years is defined as the rate of patients with surgery at 2 years., Quality of life: Quality of life will be assessed according to the questionnaire of EORTC QLQ-C30 and QLQ-CR29 scales (at baseline, 3, 6, 12 and 24 months). Scores will be described at inclusion by treatment arm. The time to final deterioration of the global health score will be calculated: it is defined as the time from the date of randomisation to the date of deterioration of more than 10 points compared to the inclusion score (without any improvement later) or death. Alive patients without d, Objective response rate (ORR): Objective Response rate is defined by patients with partial or complete response. The best tumor response will be evaluated throughout the treatment. The response is evaluated according to the various categories: complete, partial, stability, progression or non-evaluable response.

Source: https://euclinicaltrials.eu/ctis-public/view/2024-510772-20-00